EU clinical trial 2024-516304-42-00: Early recognition of progressive lung fibrosis in systemic rheumatic diseases: a characterization of the pulmonary environment through extracellular vesicles, advanced and functional imaging
Protocol code: COOPERATION 2.0
Sponsor: Fondazione Policlinico Universitario Agostino Gemelli IRCCS (Hospital/Clinic/Other health care facility). Phase: Therapeutic exploratory (Phase II). Countries: Italy (ongoing, recruitment ended).
Therapeutic area(s): Diseases [C] - Respiratory Tract Diseases [C08]; Diseases [C] - Skin and Connective Tissue Diseases [C17]
Gender: Female, Male. Age: 18-64 years, 65+ years. Enrolment: 35.
Status: Ongoing, recruitment ended. Start date (EU): 2025-05-30. Decision date: 2024-11-11. Results received: No. Last updated: 2024-11-11.

Condition(s): Patients with connective tissue diseases at high risk of interstial lung disease

Primary endpoint: The following measures will be evaluated in FAPI PET-CT: pattern and distribution of FAPI uptake, mean and maximum Standardized Uptake Value (SUV mean and SUV max) of pulmonary fibrotic lesions, fibrotic active volume (FAV), total fibrosis (calculated as the product of SUV mean and the fibrotic active volume), uptake ratio between fibrotic and healthy lung tissue. These measures will be compared between CTD-ILD patients with and without progressive phenotypes at the 12-month follow-up
Endpoint(s): AI-collected measures of lung anatomy (including lung texture, airway, and vascular measures) and serum EV single-protein quantity and RNA expression measures, Exploratory endpoint: BALF EV single-protein quantity and RNA expression measures

Source: https://euclinicaltrials.eu/ctis-public/view/2024-516304-42-00